EU clinical trial 2026-525220-15-00: A phase 1b trial to study the safety and effect of ZP9830 in patients with plaque psoriasis
Protocol code: ZP9830-25204
Sponsor: Zealand Pharma A/S (Pharmaceutical company). Phase: Human Pharmacology (Phase I)- Other. Countries: Netherlands (ongoing, recruiting).
Therapeutic area(s): Diseases [C] - Skin and Connective Tissue Diseases [C17]
Gender: Female, Male. Age: 18-64 years. Enrolment: 32.
Status: Ongoing, recruiting. Start date (EU): 2026-07-09. Decision date: 2026-07-01. Results received: No. Last updated: 2026-07-01.

Condition(s): Plaque Psoriasis

Source: https://euclinicaltrials.eu/ctis-public/view/2026-525220-15-00